EU clinical trial 2023-508395-11-00: A randomised, double-blind, placebo-controlled, dose-finding study evaluating efficacy, safety and tolerability of different doses of BI 1819479 over at least 24 weeks in patients with idiopathic pulmonary fibrosis (IPF).
Protocol code: 1462-0004
Sponsor: Boehringer Ingelheim International GmbH, Boehringer Ingelheim Espana S.A. (Pharmaceutical company). Phase: Therapeutic exploratory (Phase II). Countries: Norway (ended), Germany (ended), Italy (ended), Austria (ended), Finland (ended), Poland (ended), Hungary (ended), Denmark (ended), Belgium (ended), Spain (ended), France (ended), Sweden (ended), Greece (ended), Czechia (ended).
Therapeutic area(s): Diseases [C] - Respiratory Tract Diseases [C08]
Gender: Female, Male. Age: 18-64 years, 65+ years. Enrolment: 123.
Status: Ended. Start date (EU): 2024-09-10. End date (EU): 2026-01-09. End date: 2026-01-16. Decision date: 2024-08-29. Results received: No. Last updated: 2026-02-24.
Decision dates by country: DK: 2024-09-02, GR: 2024-09-09, ES: 2024-08-30, NO: 2024-08-29, AT: 2024-09-02, BE: 2024-08-29, CZ: 2024-09-04, DE: 2024-08-30, FI: 2024-09-03, FR: 2024-08-30, HU: 2024-09-09, SE: 2024-09-02, PL: 2024-09-04, IT: 2024-09-02

Condition(s): idiopathic pulmonary fibrosis
Product: BI 1819479, Placebo, Film-coated tablet, matching in size, weight, colour and shape to BI 1819479 (both unit strengths), BI 1819479

Primary endpoint: Annual rate of decline in FVC [mL/year] assessed over a treatment period up to a maximum of 52 weeks
Endpoint(s): Absolute change from baseline in FVC at Week 24 [in mL]

Source: https://euclinicaltrials.eu/ctis-public/view/2023-508395-11-00